EU clinical trial 2025-523141-10-00: A Phase 2b, Multicenter, Randomized, Double-blind, Placebo-controlled, Dose-ranging Study to Evaluate the Efficacy and Safety of JNJ-88545223 for the Treatment of Participants with Active Psoriatic Arthritis
Protocol code: 88545223PSA2001
Sponsor: Janssen Cilag International (Pharmaceutical company). Phase: Therapeutic exploratory (Phase II). Countries: Spain (ongoing, recruiting), Poland (ongoing, recruiting), Czechia (ongoing, recruiting), Germany (ongoing, recruiting), Hungary (ongoing, recruiting).
Therapeutic area(s): Diseases [C] - Immune System Diseases [C20]
Gender: Female, Male. Age: 18-64 years, 65+ years. Enrolment: 160.
Status: Ongoing, recruiting. Start date (EU): 2026-03-20. Decision date: 2026-03-20. Results received: No. Last updated: 2026-05-21.
Decision dates by country: CZ: 2026-03-20, DE: 2026-03-20, ES: 2026-03-25, PL: 2026-03-27, HU: 2026-05-21

Condition(s): Active Psoriatic Arthritis
Product: JNJ-88545223, JNJ-88545223, JNJ-88545223 Placebo

Primary endpoint: ACR50 response at Week 16.

Source: https://euclinicaltrials.eu/ctis-public/view/2025-523141-10-00